EU clinical trial 2024-511646-40-00: A Phase IB/II, 2-Stage, Open-label, Multicenter Study to Determine the Efficacy and Safety of Durvalumab (MEDI4736) + Paclitaxel and Durvalumab (MEDI4736) in Combination With Novel Oncology Therapies With or Without Paclitaxel for First-line Metastatic Triple Negative Breast Cancer (BEGONIA)
Protocol code: D933LC00001
Sponsor: AstraZeneca AB (Pharmaceutical company). Phase: Phase I and Phase II (Integrated)- Other. Countries: Poland (ongoing, recruitment ended).
Therapeutic area(s): Diseases [C] - Neoplasms [C04]
Gender: Female. Age: 18-64 years, 65+ years. Enrolment: 61.
Status: Ongoing, recruitment ended. Start date (EU): 2019-07-11. Decision date: 2024-08-09. Results received: No. Last updated: 2025-07-14.

Condition(s): First-line (1L) Stage IV Triple Negative Breast Cancer (TNBC) - the subtype of breast cancer characterized by a lack of tumor expression of estrogen receptor, progesterone receptor, and human epidermal growth factor receptor 2.
Product: Oleclumab, INFLIXIMAB, IMFINZI 50 mg/mL concentrate for solution for infusion., Datopotamab deruxtecan, PACLITAXEL, Capivasertib, DS-8201a

Primary endpoint: Part 1: AEs, exposure, physical examinations, laboratory findings, and vital signs, Part 2: Endpoints based on Investigator assessment according to RECIST 1.1: ORR (objective response rate): The percentage of evaluable patients with a confirmed Investigator-assessed visit response of CR (complete response) or PR (partial response).
Endpoint(s): Part 1: Endpoints based on Investigator assessment according to RECIST 1.1: ORR (objective response rate): The percentage of evaluable patients with a confirmed Investigator-assessed visit response of CR (complete response) or PR (partial response), Part 1: Endpoints based on Investigator assessment according to RECIST 1.1: PFS (progression-free survival): Time from date of first dose until the date of objective radiological disease progression using RECIST 1.1 or death (by any cause in the absence of progression, Part 1: Endpoints based on Investigator assessment according to RECIST 1.1: DoR (duration of response): Time from date of first detection of objective response (which is subsequently confirmed) until the date of objective radiological disease progression, Part 1: Endpoints based on Investigator assessment according to RECIST 1.1: OS (overall survival): Time from date of first dose until the date of death by any cause, Part 1: Serum concentration of durvalumab and serum or plasma concentration of novel oncology therapies, Part 1: Presence of ADAs for durvalumab and applicable novel oncology therapies, Part 2: Endpoints based on Investigator assessment according to RECIST 1.1: PFS (progression-free survival): Time from date of first dose until the date of objective radiological disease progression using RECIST 1.1 or death (by any cause in the absence of progression), Part 2: Endpoints based on Investigator assessment according to RECIST 1.1: DoR (duration of response): Time from date of first detection of objective response (which is subsequently confirmed) until the date of objective radiological disease progression, Part 2: Endpoints based on Investigator assessment according to RECIST 1.1: PFS6: PFS at 6 months following date of first dose, Part 2: Endpoints based on Investigator assessment according to RECIST 1.1: OS (overall survival): Time from date of first dose until the date of death by any cause, Part 2: AEs, exposure, physical examinations, laboratory findings, and vital signs

Source: https://euclinicaltrials.eu/ctis-public/view/2024-511646-40-00